EU clinical trial 2024-517880-22-00: FORMA – a multicentre randomized-controlled trial to evaluate the efficacy and safety of ketoanalogues of essential amino acids in prophylaxis of protein-energy wasting in nephrotic syndrome.
Protocol code: ABM/FORMA/2021
Sponsor: Wojskowy Instytut Medyczny Panstwowy Instytut Badawczy (Hospital/Clinic/Other health care facility). Phase: Therapeutic confirmatory (Phase III). Countries: Poland (ongoing, recruiting).
Therapeutic area(s): Not possible to specify
Gender: Female, Male. Age: 18-64 years, 65+ years. Enrolment: 150.
Status: Ongoing, recruiting. Start date (EU): 2023-01-04. Decision date: 2024-12-02. Results received: No. Last updated: 2026-03-25.

Condition(s): Protein-energy wasting in nephrotic syndrome
Product: KETOSTERIL, tabletki powlekane

Primary endpoint: Change in lean body mass from baseline within 6 weeks after enrollment in the study (non-inferiority).
Endpoint(s): Change in lean body mass from baseline within 6 weeks after enrollment in the study (superiority)., Change in handgrip strength value of the dominant handwithin 6 weeks after enrollment in the study., Change from baseline in serum albumin concentration at Week 6., Change from baseline in urine protein-to-creatinine ratio (uPCR) at Week 6., Change from baseline in serum low-density lipoprotein (LDL) concentration at Week 6., Change from baseline in serum triglyceride concentration at Week 6., Change from baseline in serum uric acid concentration at Week 6., Safety assessment including the analysis of adverse events (according to CTCAE and MedDRA), evaluation of the relationship between adverse events and the investigational medicinal product, and analysis of selected laboratory parameters during the treatment period, the mandatory follow-up period, and the observation period.

Source: https://euclinicaltrials.eu/ctis-public/view/2024-517880-22-00